EU clinical trial 2023-507703-63-00: A Phase 1/2 Study of the Oral RET Inhibitor LOXO-292 in Pediatric Patients with Advanced RET-Altered Solid or Primary Central Nervous System Tumors
Protocol code: LOXO-RET-18036
Sponsor: Loxo Oncology Inc. (Pharmaceutical company). Phase: Phase I and Phase II (Integrated)- Other. Countries: Denmark (ended), France (ongoing, recruitment ended), Germany (ended), Spain (ongoing, recruitment ended), Italy (ongoing, recruitment ended).
Therapeutic area(s): Diseases [C] - Neoplasms [C04]
Gender: Female, Male. Age: 0-17 years, 18-64 years. Enrolment: 25.
Start date (EU): 2020-05-04. Decision date: 2024-06-18. Results received: No. Last updated: 2026-03-05.
Decision dates by country: DK: 2024-06-18, DE: 2024-06-21, FR: 2024-06-21, IT: 2024-06-26, ES: 2024-06-20

Condition(s): Pediatric Patients with Advanced RET-Altered Solid or Primary Central Nervous System Tumors
Product: SELPERCATINIB, Selpercatinib, Selpercatinib, SELPERCATINIB, Selpercatinib

Primary endpoint: PHASE 1 Frequency, severity and relatedness of TEAEs and SAEs, including DLTs in pediatric patients receiving selpercatinib, PHASE 2 ORR based on RECIST v 1.1 or RANO as appropriate to tumor type as determined by an IRC

Source: https://euclinicaltrials.eu/ctis-public/view/2023-507703-63-00